EU clinical trial 2023-505278-13-00: JAKIH « A phase 2 open-label single-arm trial of JAK1 inhibitor for the treatment of large inflammatory hepatocellular adenomas »
Protocol code: APHP220916
Sponsor: Assistance Publique Hopitaux De Paris (Hospital/Clinic/Other health care facility). Phase: Therapeutic exploratory (Phase II). Countries: France (ongoing, recruitment ended).
Therapeutic area(s): Diseases [C] - Digestive System Diseases [C06]
Gender: Female, Male. Age: 18-64 years, 65+ years. Enrolment: 50.
Status: Ongoing, recruitment ended. Start date (EU): 2024-10-01. Decision date: 2024-03-22. Results received: No. Last updated: 2026-04-20.

Condition(s): -women with an inflammatory HCA proven at histology and with at least one inflammatory HCA of more than 5 cm. -male with at least one inflammatory HCA proven at histology whatever the size and considered as non resectable by the multidisciplinary tumor board
Product: Olumiant 2 mg film-coated tablets, Olumiant 4 mg film-coated tablets

Primary endpoint: The primary endpoint is that the experimental procedure (baricitinib 4 mg per day) led to a decrease of the target lesion size of at least 30% at 6 months MRI (without progression of the other lesions in cases of multiples HCA) in at least 50% of the patients according to RECIST 1.1 criteria (corresponding to the definition of partial or complete response) assessed by a blind centralized reading
Endpoint(s): Proportion of overall radiological response (partial and complete response), stable disease, and progressive disease using RECIST 1.1 criteria at 3 months and 6 months MRI, Proportion of target lesions (inflammatory HCA > 5 cm) showing a decrease in size below 5 cm at 3 months and 6 months MRI using RECIST 1.1 thus modified RECIST criteria at MRI, Proportion patients treated by liver surgery for HCA at 6 months and the end of the 24 months follow-up, Adverse events within the 24 months of the study related to the experimental treatment (baricitinib) a) all adverse events b) occurrence of zona c) cancer d) major adverse cardiovascular events (MACE), In patients with multiple HCA, the proportion patients with complete response, partial response, stable disease and progressive disease focusing on other HCA excluding the inflammatory HCA confirmed at histology according to RECIST 1.1 criteria at MRI at 3 months and 6 months., Proportion of symptomatic bleeding of HCA during follow-up, Proportion of malignant transformation in HCC during follow-up at histology and confirmed by a multidisciplinary tumor board, Proportion of patients with a progressive disease between baricitinib discontinuation (6 months) and 24 months of follow-up using RECIST 1.1 criteria at imaging, Proportion of patients with an increase in tumor size below 5 cm between baricitinib discontinuation (6 months) and 24 months at MRI, Proportion of post-operative adverse events (using the Dindo-Clavien Classification) if liver surgery is required during follow-up

Source: https://euclinicaltrials.eu/ctis-public/view/2023-505278-13-00